EU clinical trial 2025-522586-30-00: A Phase 3, Multicenter, Long-Term Extension Study to Evaluate the Long-Term Safety, Tolerability, and Efficacy of Zasocitinib (TAK-279) in Subjects With Active Psoriatic Arthritis Who are Either Biologic DMARD-Naïve or Biologic DMARD-Experienced, Including Those With Inadequate Response to Biologic DMARDs
Protocol code: TAK-279-PsA-3003
Sponsor: Takeda Development Center Americas Inc. (Pharmaceutical company). Phase: Therapeutic confirmatory (Phase III). Countries: Germany (authorised, recruiting), Belgium (authorised, recruitment pending), Spain (authorised, recruitment pending), Czechia (authorised, recruiting), Croatia (authorised, recruitment pending), Portugal (authorised, recruitment pending), Poland (ongoing, recruiting), Latvia (authorised, recruiting), Bulgaria (authorised, recruitment pending), France (authorised, recruitment pending), Estonia (ongoing, recruiting), Hungary (authorised, recruitment pending), Italy (authorised, recruitment pending).
Therapeutic area(s): Diseases [C] - Musculoskeletal Diseases [C05]
Gender: Female, Male. Age: 18-64 years, 65+ years. Enrolment: 638.
Start date (EU): 2026-06-16. Decision date: 2026-05-12. Results received: No. Last updated: 2026-07-22.
Decision dates by country: BG: 2026-05-18, HR: 2026-05-25, EE: 2026-05-18, FR: 2026-05-18, DE: 2026-05-13, IT: 2026-05-20, LV: 2026-05-13, PT: 2026-05-12, PL: 2026-05-25, CZ: 2026-05-12, BE: 2026-05-18, HU: 2026-05-19, ES: 2026-05-18

Condition(s): Psoriatic Arthritis
Product: Matching Placebo for TAK-279 Dose A, Matching Placebo for TAK-279 Dose B, ZASOCITINIB, ZASOCITINIB

Primary endpoint: Incidence of treatment-emergent adverse events, Incidence of serious adverse events, Incidence of adverse events of special interest, Changes in vital signs and clinical laboratory parameters.
Endpoint(s): American College of Rheumatology (ACR)20 response: Assessed as proportion of subjects achieving ACR20 at Weeks 24, 48, and 104., ACR50 response: Assessed as proportion of subjects achieving ACR50 at Weeks 24, 48, and 104., ACR70 response: Assessed as proportion of subjects achieving ACR70 at Weeks 24, 48, and 104., Minimal disease activity (MDA): Assessed as proportion of subjects achieving MDA status at Weeks 24, 48, and 104., Psoriasis Area and Severity Index (PASI)75 (in subjects with a baseline ≥3% body surface area): Assessed as proportion of subjects achieving ≥75% improvement from baseline in PASI score at Weeks 24, 48, and 104.

Source: https://euclinicaltrials.eu/ctis-public/view/2025-522586-30-00